EU clinical trial 2024-515495-13-00: A Phase 3, Randomized, Double-blind, Placebo-controlled Study to evaluate Efficacy and Safety of Empagliflozin in the prevention of Cardiotoxicity in Cancer patients undergoing Chemotherapy based on Anthracyclines (EMPACT study)
Protocol code: 2021/ABM/03/00012
Sponsor: Narodowy Instytut Onkologii Im. Marii Sklodowskiej-Curie Panstwowy Instytut Badawczy (Hospital/Clinic/Other health care facility). Phase: Therapeutic confirmatory (Phase III). Countries: Poland (ongoing, recruiting).
Therapeutic area(s): Diseases [C] - Cardiovascular Diseases [C14]
Gender: Female, Male. Age: 18-64 years, 65+ years. Enrolment: 220.
Status: Ongoing, recruiting. Start date (EU): 2023-07-06. Decision date: 2024-07-29. Results received: No. Last updated: 2025-10-21.

Condition(s): Cardiotoxicity. The study population will consist of patients diagnosed with cancer, without history of heart failure and LV ejection fraction (EF) ≥ 50%, scheduled for high dose anthracyclines (doxorubicin ≥240 mg/m2 or epirubicin ≥360 mg/m2) as standard of care (SoC) systemic anticancer treatment.
Product: Placebo equivalent to empagliflozin without active substances, Jardiance 10 mg film-coated tablets

Primary endpoint: Time to first event of left ventricular systolic dysfunction. Criterion for the diagnosis of left ventricular systolic dysfunction in echocardiography: reduction of left ventricular ejection fraction (LVEF)> 10 percentage points from baseline to <50%
Endpoint(s): Overall response rate 1. Composite secondary endpoint • all-cause death • cardiovascular death • myocardial infarction • stroke 2. Other: • decrease in GLS (global longitudinal strain) • structural myocardial alterations in CMR • changes in the concentration of biomarkers in blood samples (Troponin T, NTproBNP), Incidence and intensity of Adverse events (AEs), including serious AEs (SAEs).Withdrawal from study drug due to AEs • Clinically relevant changes in laboratory assessments from baseline. • Clinically relevant new finding or worsening of existing condition on physical examination • Assessment of vital status. AESIs: ketoacidosis, lower limb amputation • Laboratory parameters: hematology, serum chemistry, lipids profile, and urinalysis.Physical Examination •Vital Status: SBP, DBP and pulse rate

Source: https://euclinicaltrials.eu/ctis-public/view/2024-515495-13-00